EU clinical trial 2025-521640-38-00: Open Label Extension Clinical Trial of Vormatrigine in Adult Patients with Epilepsy.
Protocol code: PRAX-628-323
Sponsor: Praxis Precision Medicines Inc. (Pharmaceutical company). Phase: Therapeutic confirmatory (Phase III). Countries: Germany (ongoing, recruiting), Spain (ongoing, recruiting), Poland (ongoing, recruiting), Italy (ongoing, recruiting).
Therapeutic area(s): Diseases [C] - Nervous System Diseases [C10]
Gender: Female, Male. Age: 18-64 years, 65+ years. Enrolment: 56.
Status: Ongoing, recruiting. Start date (EU): 2025-10-16. Decision date: 2025-10-06. Results received: No. Last updated: 2026-02-16.
Decision dates by country: DE: 2025-10-08, ES: 2025-10-09, PL: 2025-10-10, IT: 2025-10-06

Condition(s): Focal onset seizures or primary generalized tonic-clonic seizures.
Product: PRAX-628, PRAX-628, PRAX-628, PRAX-628

Primary endpoint: - Incidence and severity of treatment-emergent adverse events (TEAEs), including discontinuation of study drug due to TEAEs. - Changes in vital sign measurements. - Changes in clinical laboratory results. - Changes in electrocardiogram parameters. - Changes in suicidality, as assessed by Columbia Suicide Severity Rating Scale (C-SSRS)
Endpoint(s): (EXPLORATORY) Percent change in monthly (28 days) focal or generalized seizure frequency from the Screening/Observation Period of the primary trial., (EXPLORATORY) Change from baseline over time in PGI-S and CGI-S., (EXPLORATORY) Vormatrigine plasma concentrations, (EXPLORATORY) PGI-C, CGI-C, and CaGI-C (if applicable) assessed overtime post-screening.

Source: https://euclinicaltrials.eu/ctis-public/view/2025-521640-38-00